EU clinical trial 2024-512637-32-00: ASPIRO: A Phase 1/2/3, Randomized, Open-Label, Ascending-Dose, Delayed-Treatment Concurrent Control Clinical Study to Evaluate the Safety and Efficacy of AT132, an AAV8-Delivered Gene Therapy in X-Linked Myotubular Myopathy (XLMTM) Patients
Protocol code: ATX-MTM-002
Sponsor: Astellas Gene Therapies Inc. (Pharmaceutical company). Phase: Phase II and Phase III (Integrated). Countries: Germany (ongoing, recruitment ended), France (ongoing, recruitment ended).
Therapeutic area(s): Diseases [C] - Musculoskeletal Diseases [C05]
Gender: Male. Age: 0-17 years. Enrolment: 5.
Status: Ongoing, recruitment ended. Start date (EU): 2018-08-21. Decision date: 2024-05-02. Results received: No. Last updated: 2025-10-06.
Decision dates by country: FR: 2024-05-14, DE: 2024-05-02

Condition(s): X-linked Myotubular Myopathy (XLMTM)
Product: AT132

Primary endpoint: Primary Efficacy Endpoint: • Change from baseline in hours of ventilation support at Week 24
Endpoint(s): Key Secondary Efficacy Endpoint: Percentage of subjects achieving functionally independent sitting for at least 30 seconds at Week 24, Other Secondary Efficacy Endpoints: • Time to reduction in required ventilator support to ≤ 16 hours a day (only in subjects who require invasive ventilation) at Week 24, • Change from baseline in Children's Hospital of Philadelphia Infant Test of Neuromuscular Disorders (CHOP INTEND) at Week 24, • Change from baseline in maximal inspiratory pressure (MIP) at Week 24, • Change from baseline in quantitative analysis of myotubularin expression in the muscle biopsy at Week 24, • Change from baseline in quality of life assessments at Week 24 (ie, the Assessment of Caregiver Experience with Neuromuscular Disease [ACEND] and Pediatric Quality of Life Inventory [PedsQL]), • Number (%) of age-appropriate clinically relevant gross motor function milestones attained through Week 24, • Percentage of subjects achieving full ventilator independence at Week 24, •Survival, 10 Safety Endpoints: • Adverse events (AEs), serious AEs (SAEs), and findings from safety laboratory tests, 12-lead ECG, echocardiograms (ECHOs), vital signs, growth parameters, physical examinations, liver ultrasounds, antibody formation (anti AAV8, anti MTM1), viral shedding , annualized hospitalization rate , annualized respiratory and non-respiratory SAE rate, and length of stay per hospitalization

Source: https://euclinicaltrials.eu/ctis-public/view/2024-512637-32-00